EU clinical trial 2026-525269-34-00: Skin irritation and sensitization trial
Protocol code: CCO26001
Sponsor: CCDRD Cooperative Clinical Drug Research and Development AG, Corium Innovations Inc. (Pharmaceutical company). Phase: Human Pharmacology (Phase I)- Other. Countries: Bulgaria (ongoing, recruiting).
Therapeutic area(s): Psychiatry and Psychology [F] - Mental Disorders [F03]
Gender: Female, Male. Age: 18-64 years. Enrolment: 230.
Status: Ongoing, recruiting. Start date (EU): 2026-06-30. Decision date: 2026-06-26. Results received: No. Last updated: 2026-06-26.

Condition(s): The intended indication is for the treatment of major depressive disorder.

Source: https://euclinicaltrials.eu/ctis-public/view/2026-525269-34-00